EU clinical trial 2025-524386-24-00: A randomized, open-label, Phase III trial to assess the efficacy and safety of BupiZenge compared to lidocaine for pain associated with oral mucositis in head and neck cancer
Protocol code: BZ003
Sponsor: OncoZenge AB (Pharmaceutical company). Phase: Therapeutic confirmatory (Phase III). Countries: Germany (authorised, recruitment pending), Denmark (ongoing, recruiting), Norway (ongoing, recruiting), Sweden (ongoing, recruiting).
Therapeutic area(s): Analytical, Diagnostic and Therapeutic Techniques and Equipment [E] - Anesthesia and Analgesia [E03]; Diseases [C] - Neoplasms [C04]
Gender: Female, Male. Age: 18-64 years, 65+ years. Enrolment: 150.
Start date (EU): 2026-06-25. Decision date: 2026-04-28. Results received: No. Last updated: 2026-08-07.
Decision dates by country: DE: 2026-04-29, NO: 2026-05-21, SE: 2026-04-28, DK: 2026-04-28

Condition(s): Head and neck cancer, Oral mucositis
Product: BupiZenge, Lidocaine

Primary endpoint: Total pain reduction from baseline expressed as area under the curve (AUC) of patient-reported oral cavity pain intensity from pre-dose to 3 hours post-dose, measured by the NRS (patient-reported at site) at the last day of radiotherapy, comparing BupiZenge with lidocaine.
Endpoint(s): Total pain reduction from baseline, expressed as AUC of patient-reported oral cavity pain intensity from pre-dose to 3 hours post-dose, measured by the NRS (patient-reported at site) at day 1 and at each of week 1 to 3 of treatment with BupiZenge/lidocaine comparing BupiZenge with lidocaine., Proportion of responders defined as a 30% reduction in pain NRS AUC0-3h compared to baseline at the last day of radiotherapy and at each of weeks 1 to 3, comparing BupiZenge with lidocaine., Change from pre-dose (on same day) in oral cavity pain intensity at 15 minutes post-dose (NRS; patient-reported at home), comparing BupiZenge with viscous lidocaine at the week preceding end of radiotherapy and at each of week 1 to week 3 after radiotherapy (including only data when participants on concomitant radiotherapy) (weekly means)., Change from pre-dose (on same day) in oral cavity pain intensity at 60 minutes post-dose (NRS; patient-reported at home), comparing BupiZenge with viscous lidocaine at the week preceding end of radiotherapy and at each of week 1 to week 3 after radiotherapy (including only data when participants on concomitant radiotherapy) (weekly means)., Change from pre-dose (day 1) in oral cavity pain intensity to pre-dose (NRS; patient-reported at home), comparing BupiZenge with viscous lidocaine at the week preceding end of radiotherapy and at each of week 1 to week 3 after radiotherapy (including only data when participants on concomitant radiotherapy) (weekly means), Safety: Frequency and severity of AEs and SAEs as per common terminology criteria for AEs (CTCAE) v6, including changes from baseline in safety laboratory values, body weight, and vital signs, Tolerability: Incidence of dose modifications due to AEs/SAEs, Local tolerability in the oral cavity as per visual inspection by the investigator, Oral consumption of opioids during the treatment period with concomitant BupiZenge/lidocaine treatment and radiotherapy quantified as oral morphine milligram equivalents (MME) per day comparing BupiZenge with lidocaine., Time (days) to initiation of opioid medication during concomitant radiotherapy counted from day of randomization, comparing BupiZenge with lidocaine, Change from baseline to last day of radiotherapy in mOMDQ Total Score, comparing BupiZenge with lidocaine, Change from baseline to last day of radiotherapy in RAND SF-36 Physical Component Summary (PCS) score, comparing BupiZenge with lidocaine, Proportion of participants who progress from WHO Grade 2 to Grade 3 or higher during the treatment period with concomitant radiotherapy, comparing BupiZenge with lidocaine, PK parameters in plasma including but not limited to; time vs concentration profiles, AUC0-3h, Cmax, and Tmax, HRUQ Total Score assessed at 30 days post-treatment, WPAI Total Score assessed as change from baseline to 30 days post-treatment

Source: https://euclinicaltrials.eu/ctis-public/view/2025-524386-24-00